EU clinical trial 2024-520093-34-00: Stereotactic body radiation therapy on Prostate with or without Androgen deprivation therapy, a phase III randomized controlled trial (SPA Trial)
Protocol code: ASST-FRADIO-SPA-2020
Sponsor: Azienda Socio Sanitaria Territoriale Degli Spedali Civili Di Brescia (Hospital/Clinic/Other health care facility). Phase: Therapeutic confirmatory (Phase III). Countries: Italy (authorised, recruitment pending).
Therapeutic area(s): Diseases [C] - Neoplasms [C04]
Gender: Male. Age: 18-64 years, 65+ years. Enrolment: 310.
Status: Authorised, recruitment pending. Decision date: 2025-01-31. Results received: No. Last updated: 2025-07-24.

Condition(s): Acinar cell prostatic carcinoma
Product: DECAPEPTYL 22,5 mg / 2ml - Polvere e solvente per sospensione iniettabile a rilascio prolungato, Casodex 50 mg comprimate filmate

Primary endpoint: • To determinate if there is improvement in biochemical Disease free survival (bDFS, defined as PSA elevation ≥ 2 ng/ml over Nadir, following the Phoenix criteria*) in patients treated with prostate SBRT + ADT (ARM A) compared to patients treated with SBRT alone (ARM B).
Endpoint(s): • Disease free survival (DFS, defined as evidence of biochemical, local, regional or distant relapse on imaging)., • Freedom from local recurrence (FFLR, defined as evidence of in-field recurrence detected at imaging and/or Histologically proved), • Freedom from regional recurrence (FFRR, defined as evidence of out-of field recurrence in the true pelvis as defined by TNM VIII criteria for regional node), • Freedom from distant metastasis (FFDM, defined as evidence of out of field recurrence that meets the criteria of M1 defined by TNM VIII), • Overall Survival (OS, defined as death for any cause)

Source: https://euclinicaltrials.eu/ctis-public/view/2024-520093-34-00